EU clinical trial 2023-508549-41-00: SOLTI-1904: EfficACy of tislelizumab and spartalizumab acROss multiPle cancer-types in patients with PD1-high mRNA expressing tumOrs defined by a singLe and pre-specIfied cutoff (ACROPOLI trial)
Sponsor: Solti Group (Pharmaceutical company). Phase: Therapeutic exploratory (Phase II). Countries: Spain (ended).
Therapeutic area(s): Diseases [C] - Neoplasms [C04]
Gender: Female, Male. Age: 18-64 years, 65+ years. Enrolment: 184.
Status: Ended. Start date (EU): 2021-04-30. End date (EU): 2025-07-31. Decision date: 2024-10-11. Results received: Yes. Last updated: 2025-05-19.

Condition(s): Metastatic disease
Product: Tevimbra 100 mg concentrate for solution for infusion, Tevimbra 100 mg concentrate for solution for infusion, PDR001, Tevimbra 100 mg concentrate for solution for infusion, Tevimbra 100 mg concentrate for solution for infusion

Primary endpoint: Overall Response rate (ORR) defined as the proportion of patients with best overall response of complete response (CR) or partial response (PR), as per local investigator´s assessment and according to Response Evaluation Criteria in Solid Tumors (RECIST) version 1.1 criteria.
Endpoint(s): Clinical Benefit Rate (CBR) defined as the proportion of patients with a best overall response of CR, PR or an overall lesion response of Stable Disease (SD) or Non-PR/Non-progression disease (PD) lasting ≥ 24 weeks, based on local investigator´s assessment according to RECIST v1.1., Progression free survival (PFS) defined as the time from allocation to the first occurrence of disease progression, as determined locally by the investigator using RECIST v.1.1, or death from any cause, whichever occurs first., Duration of response (DoR) defined as the time from the first occurrence of a documented objective response to disease progression, as determined locally by the investigator through use of RECIST v.1.1, or death from any cause, whichever occurs first., Time to response (TtR) defined as the time from allocation to the first objective tumor response (tumor shrinkage of ≥30%) observed for patients who achieved a CR or PR., Overall survival (OS) defined as the time from allocation to death from any cause (OS will be determined at the end of the study). 1.6. PFS on study treatment compared to PFS on prior line of therapy (pre-PFS)., ORR as per local investigator´s assessment and according to RECIST v1.1., CBR based on local investigator´s assessment according to RECIST v1.1., PFS as determined locally by the investigator using RECIST v.1.1, or death from any cause, whichever occurs first., DoR as determined locally by the investigator through use of RECIST v.1.1, or death from any cause, whichever occurs first, TtR observed for patients who achieved a CR or PR., OS defined as the time from allocation to death from any cause., PFS on study treatment compared to PFS on prior line of therapy (pre-PFS)., Incidence, seriousness, treatment-related and severity (grade) of Treatment Emergent Adverse Events (TEAEs) assessed by the NCI Common Terminology for Classification of Adverse Events (CTCAE) version 5, including delays and treatment discontinuations., Frequency of clinically significant abnormalities in physical examination, safety laboratory tests, urinalysis and vital signs.

Source: https://euclinicaltrials.eu/ctis-public/view/2023-508549-41-00